EU clinical trial 2024-512734-15-00: A Phase 1, First-in-Human, Open-Label Study of the Safety, Pharmacokinetics, and Pharmacodynamics of JNJ-67856633, an Inhibitor of MALT1, in Participants With NHL and CLL
Protocol code: 67856633LYM1001
Sponsor: Janssen Cilag International (Pharmaceutical company). Phase: Human Pharmacology (Phase I)- First administration to humans. Countries: France (ended), Greece (ended).
Therapeutic area(s): Diseases [C] - Neoplasms [C04]
Gender: Female, Male. Age: 18-64 years, 65+ years. Enrolment: 60.
Status: Ended. Start date (EU): 2019-10-23. End date (EU): 2025-03-17. End date: 2025-05-22. Decision date: 2024-07-22. Results received: No. Last updated: 2024-07-26.
Decision dates by country: FR: 2024-07-26, GR: 2024-07-22

Condition(s): Non-Hodgkin lymphoma and chronic lymphocytic leukemia

Source: https://euclinicaltrials.eu/ctis-public/view/2024-512734-15-00